EU clinical trial 2023-504593-38-00: An exploratory, open label, multiple dose, multicentre phase I/II trial evaluating safety and efficacy of postnatal or prenatal and postnatal intravenous administration of allogeneic expanded fetal mesenchymal stem cells for the treatment of severe Osteogenesis Imperfecta compared with a combination of historical and untreated prospective controls.
Protocol code: KIBB01
Sponsor: Karolinska Institutet (Educational Institution). Phase: Phase I and Phase II (Integrated)- Other. Countries: Netherlands (ongoing, recruitment ended), Sweden (ongoing, recruitment ended).
Therapeutic area(s): Diseases [C] - Congenital, Hereditary, and Neonatal Diseases and Abnormalities [C16]
Gender: Female, Male. Age: In utero, 0-17 years, 18-64 years. Enrolment: 138.
Status: Ongoing, recruitment ended. Start date (EU): 2019-08-12. Decision date: 2024-08-29. Results received: No. Last updated: 2024-09-02.
Decision dates by country: SE: 2024-08-29, NL: 2024-09-02

Condition(s): Osteogenesis Imperfecta (OI) type III and severe type IV. Severe type of congenital Brittle bone disease.
Product: BOOST cells

Primary endpoint: The primary endpoints are seriousness, severity and frequency of treatment-related AEs.)
Endpoint(s): Number of fractures from baseline to primary and long-time follow-up (key secondary endpoint), Time (days) to first fracture after last dose, Number of fractures at birth (prenatal treatment group, and postnatal treatment group when available), Change in Bone mineral density (g/cm2) (supportive for the endpoint fracture frequency), Growth (cm and kg), Change in clinical status of OI based on parameters defined under efficacy assessments, Change in biochemical bone turnover

Source: https://euclinicaltrials.eu/ctis-public/view/2023-504593-38-00